EU clinical trial 2024-514283-40-00: A Phase 2, Double-blind, Randomized, Placebo-Controlled Study to Assess the Efficacy and Safety of TX000045 After 24 Weeks of Treatment in Patients With Pulmonary Hypertension Secondary to Heart Failure With Preserved Ejection Fraction (PH-HFpEF)
Protocol code: TX000045-003
Sponsor: Tectonic Therapeutic Inc. (Pharmaceutical company). Phase: Therapeutic exploratory (Phase II). Countries: Germany (ended), Spain (ongoing, recruitment ended), Bulgaria (ended), Poland (ongoing, recruitment ended), Belgium (ended), Latvia (ongoing, recruitment ended), Romania (ongoing, recruitment ended), Austria (ended), Portugal (ended).
Therapeutic area(s): Diseases [C] - Cardiovascular Diseases [C14]
Gender: Female, Male. Age: 18-64 years, 65+ years. Enrolment: 201.
Start date (EU): 2024-12-19. Decision date: 2024-11-28. Results received: No. Last updated: 2026-06-18.
Decision dates by country: PL: 2024-12-02, BE: 2025-03-05, AT: 2025-12-08, RO: 2025-02-19, DE: 2024-11-28, ES: 2024-11-28, BG: 2024-11-28, LV: 2025-03-20, PT: 2025-11-04

Condition(s): Pulmonary Hypertension
Product: sterile isotonic solution, TX000045

Primary endpoint: Mean change from baseline to Week 24 in PVR as measured by right heart catheterization (RHC) in participants with baseline PVR ≥3 Wood units who received TX000045 compared with those who received placebo, In participants who received TX000045 compared with placebo, describe: • Incidence of adverse events (AEs), adverse events of special interest (AESIs), and serious adverse events (SAEs) • Incidence of clinically significant changes from baseline in laboratory assessments, 12-lead electrocardiogram (ECG), vital sign assessments, and physical examinations
Endpoint(s): Mean change from baseline to Week 24 in PVR as measured by right heart catheterization (RHC) in participants with baseline PVR ≥3 Wood units who received TX000045 compared with those who received placebo

Source: https://euclinicaltrials.eu/ctis-public/view/2024-514283-40-00